EU clinical trial 2025-523430-14-00: A study to compare how the body absorbs different formulations of a new medicine, and how food affects drug absorption, in healthy participants
Protocol code: 88545223PSO1001
Sponsor: Janssen Cilag International (Pharmaceutical company). Phase: Human Pharmacology (Phase I)- Other. Countries: Netherlands (ended).
Therapeutic area(s): Diseases [C] - Immune System Diseases [C20]
Gender: Female, Male. Age: 18-64 years. Enrolment: 18.
Status: Ended. Start date (EU): 2025-12-24. End date (EU): 2026-05-05. Decision date: 2025-12-22. Results received: No. Last updated: 2026-04-15.

Condition(s): Psoriasis

Source: https://euclinicaltrials.eu/ctis-public/view/2025-523430-14-00